EU clinical trial 2023-508584-72-00: Pharmacokinetics, Efficacy and Safety of CT-P13 Subcutaneous as Induction Therapy in Patients with Active Crohn’s Disease or Ulcerative Colitis
Protocol code: 2023/12
Sponsor: Centre Medico Chirurgical Ambroise Pare Hartmann (Hospital/Clinic/Other health care facility). Phase: Therapeutic confirmatory (Phase III). Countries: France (ended).
Therapeutic area(s): Diseases [C] - Digestive System Diseases [C06]
Gender: Female, Male. Age: 18-64 years, 65+ years. Enrolment: 130.
Status: Ended. Start date (EU): 2024-07-10. End date (EU): 2025-05-14. Decision date: 2024-05-21. Results received: Yes. Last updated: 2024-07-30.

Condition(s): Immune Bowel Disease (including Crohn's disease and Ulcerative colitis).
Product: Remsima 100 mg powder for concentrate for solution for infusion, Remsima 100 mg powder for concentrate for solution for infusion, Remsima 120 mg solution for injection in pre-filled syringe

Primary endpoint: Ctrough measurement (residual concentration of CT-P13) at Week 6.
Endpoint(s): Ctrough measurement at Week 24., AUC assessed at Week 24., Clinical response at Week 6: • Defined for UC as a decrease in the partial Mayo score from baseline of 30% or more and 3 or more points, along with either a rectal bleeding subscore of 0 or 1 or a decrease in the rectal bleeding subscore of 1 point or more; • Defined for CD as a decrease from baseline in CDAI score of at least 100 points or a total CDAI score < 150., IBD disability index collected at Week 6., Fecal calprotectin at Week 24 (the samples are collected at Weeks 0, 6 and 24)., Clinical remission at Week 24: • Defined for UC as a total Mayo score of ≤ 2 with no individual subscore >1, and a rectal bleeding subscore of 0 at week 24 in active UC patients evaluated in semi-blind (assessment will be done by another investigator without information on the treatment); • Defined for CD as a CDAI score < 150 evaluated in semi-blind (assessment will be done by another investigator without information on the treatment)., Presence of antibodies to infliximab at Week 6 and Week 24., Concentration of CRP up to week 6 (the samples are collected at weeks 0, 6 and 24)., Adverse events, including injection site reactions and hypersensitivity reactions (from Baseline up to 6 weeks and 24 weeks)., Treatment Satisfaction Questionnaire for Medication (TSQM) collected at Week 6 and Week 24.

Source: https://euclinicaltrials.eu/ctis-public/view/2023-508584-72-00